EU clinical trial 2023-507873-16-00: Chimiothérapie à base de bevacizumab adaptée à la pharmacocinétique du bevacizumab en 1ère ligne de traitement du cancer colorectal métastatique non résécable : étude de phase 3 randomisée multicentrique en double aveugle.
Protocol code: PHARBEVACOL
Sponsor: Centre Hospitalier Regional Universitaire De Tours (Hospital/Clinic/Other health care facility). Phase: Phase III and phase IV (Integrated). Countries: France (ongoing, recruiting).
Therapeutic area(s): Diseases [C] - Digestive System Diseases [C06]
Gender: Female, Male. Age: 18-64 years, 65+ years. Enrolment: 122.
Status: Ongoing, recruiting. Start date (EU): 2025-03-04. Decision date: 2024-08-19. Results received: No. Last updated: 2024-08-19.

Condition(s): 1st line treatment for unresectable metastatic colorectal cancer
Product: CHLORURE DE SODIUM 0,9 % VIAFLO, solution pour perfusion, Avastin 25 mg/ml concentrate for solution for infusion.

Primary endpoint: The primary endpoint is progression-free survival (PFS)
Endpoint(s): 1. Safety profile defined by the number of adverse events classified according to the NCI-CTCAE5.0 classification. Particularly focused on AEs which are known to be linked to bevacizumab: hypertension, proteinuria, etc., 2. Overall survival defined as the time elapsed between the date of randomization and death (all causes),, 3. Rate of best objective tumor response according to RECIST v1.1 criteria (evaluated over the entire duration of treatment)., 4. Depth of tumor response defined as the percentage of tumor reduction observed at the lowest point., 5. Secondary resection of metastases (assessed over the entire treatment period), 6. Quality of life: EORTC QLQ-C30 and EQ5D-5L., 7. Serum concentrations of bevacizumab on day 14 of the first administration, and at 2 months from randomization (= 3 months from day 1 of the first cycle)., 8. Medical-economic analysis: estimation of the Differential Cost-Utility Ratio expressed as cost per QALY gained (year of life provided on quality) and the Differential Cost-Effectiveness Ratio expressed as cost per year of life gained.

Source: https://euclinicaltrials.eu/ctis-public/view/2023-507873-16-00